EU clinical trial 2025-524673-16-00: Effect of faecal microbiota transplant on the expression of autism spectrum disorder core symptoms in children – open-label phase II clinical trial (FMT-PAS)
Protocol code: FMT-PAS-2025
Sponsor: Masarykova Univerzita (Educational Institution). Phase: Therapeutic exploratory (Phase II). Countries: Czechia (authorised, recruitment pending).
Therapeutic area(s): Diseases [C] - Nervous System Diseases [C10]; Psychiatry and Psychology [F] - Mental Disorders [F03]
Gender: Female, Male. Age: 0-17 years. Enrolment: 20.
Status: Authorised, recruitment pending. Decision date: 2026-03-17. Results received: No. Last updated: 2026-03-17.

Condition(s): Autism spectrum disorder
Product: SUSPENSION FOR FAECAL MICROBIOTA TRANSPLANTATION

Primary endpoint: The treatment response (improvement/worsening) will be defined as ± 2 calibrated severity scores (CSS) in ADOS-2, Module 1 examination, which quantifies core symptoms intensity.
Endpoint(s): Adverse events of FMT, Bristol stool scale score, ATN-GISSI-17 questionnaire score, PEDS-QL questionnaire score, Scores in CARS2, SEQ and SDQ questionnaires

Source: https://euclinicaltrials.eu/ctis-public/view/2025-524673-16-00